EU clinical trial 2025-523293-17-00: SUNCET: Low sodium oxybate Use for Nocturnal Cluster headache: safety, Efficacy and Tolerability of XYWAV - a Phase 2 Randomized, Double-Blind, Placebo-Controlled, bi-center Study
Sponsor: Leids Universitair Medisch Centrum (LUMC) (Hospital/Clinic/Other health care facility). Phase: Therapeutic exploratory (Phase II). Countries: Netherlands (authorised, recruitment pending).
Therapeutic area(s): Diseases [C] - Nervous System Diseases [C10]
Gender: Female, Male. Age: 18-64 years, 65+ years. Enrolment: 26.
Status: Authorised, recruitment pending. Decision date: 2026-07-13. Results received: No. Last updated: 2026-07-13.

Condition(s): Cluster headache
Product: Sodium Oxybate 500 mg/mL oral solution, Low sodium oxybate placebo

Primary endpoint: Change in average weekly frequency of nocturnal cluster headache attacks during 4-week fixed stable dose treatment phase compared to baseline. Nocturnal attacks are defined as attacks occurring between the time a participant goes to bed and the time they get out of bed, with a minimum window of 8 hours after bedtime. (verum vs. placebo)
Endpoint(s): Percentage of participants with a ≥30% reduction in the weekly number of nocturnal Cluster Headache Attacks at week during 4-week fixed stable dose treatment phase compared to baseline. (verum vs placebo), Percentage of participants with a ≥50% reduction in the weekly number of nocturnal Cluster Headache Attacks at week during 4-week fixed stable dose treatment phase compared to baseline. (verum vs placebo), Percentage of participants with a 100% reduction in the weekly number of nocturnal Cluster Headache Attacks at week during 4-week fixed stable dose treatment phase compared to baseline. (verum vs placebo), Change in the weekly frequency of nocturnal cluster headache attacks that derived specifically during sleep, during the 4-week fixed stable dose treatment phase compared to baseline. (verum vs placebo), Change in weekly frequency of cluster headache attacks in a 24-hr period during 4-week fixed stable dose treatment phase compared to baseline. (verum vs placebo), Percentage of participants with a ≥30% reduction in the weekly number of cluster headache attacks in a 24-hr period (daytime and nocturnal attacks) during 4-week fixed stable dose treatment phase compared to baseline. (verum vs placebo), Percentage of participants with a ≥50% reduction in the weekly number of cluster headache attacks in a 24-hr period (daytime and nocturnal attacks) during 4-week fixed stable dose treatment phase compared to baseline. (verum vs placebo), Change in pain scale (NRS 0-10) during 4-week fixed stable dose treatment phase compared to baseline. (verum vs placebo), Change in average weekly frequency of daytime cluster headache attacks during 4-week fixed stable dose treatment phase compared to baseline. (verum vs placebo), Safety will be assessed at time points specified in the schedule of events, as well as throughout the study. Safety assessments will include the following: - Treatment-emergent adverse events (TEAEs) - Vital signs - Physical examinations (including weight) - Sleep apnoea screening (STOP-Bang) - Urine pregnancy test - Columbia-Suicide Severity Rating Scale (C-SSRS) for emergent suicidality - Patient Health Questionnaire – 9 (PHQ-9) for emergent depression, Mean change in weekly number of times an abortive medication was taken – oxygen, triptans., Change in Patient Global Impressions scale (PGI-c) score. (verum vs placebo), Change in clinical global impressions scale (CGI-c) score. (verum vs placebo), Change in Cluster Headache Quality of life scale (CHQ). (verum vs placebo), Percentage patients with improved sleep (sleep onset, sleep maintenance, sleep quality) by diary and PSQI. (verum vs placebo), Percentage of patients showing improvement in absenteeism/presenteeism, as measured by the EQ-5D. (verum vs placebo), Improvement of sleep quality as assessed by NRS. (verum vs placebo), Improvement of EDS as assessed by ESS. (verum vs placebo), Changes in sleep macrostucture (i.e. sleep onset, sleep offset). (verum vs placebo), Changes heart rate variability during sleep. (verum vs placebo), Changes in skin- and core body temperature during sleep. (verum vs placebo), Side effects, tolerability and compliance of LXB.

Source: https://euclinicaltrials.eu/ctis-public/view/2025-523293-17-00